EU clinical trial 2023-503737-22-00: An Open-Label, Phase 2, Safety, and Efficacy Study of Ruxolitinib Cream in Participants With Genital Vitiligo
Protocol code: INCB 18424-219
Sponsor: Incyte Corp. (Pharmaceutical company). Phase: Therapeutic exploratory (Phase II). Countries: France (ended).
Therapeutic area(s): Diseases [C] - Immune System Diseases [C20]
Gender: Female, Male. Age: 18-64 years, 65+ years. Enrolment: 6.
Status: Ended. Start date (EU): 2023-11-08. End date (EU): 2025-03-06. Decision date: 2023-09-12. Results received: Yes. Last updated: 2024-12-20.

Condition(s): Nonsegmental vitiligo with genital involvement
Product: Ruxolitinib cream

Primary endpoint: The primary endpoint is the proportion of participants achieving a genital VNS of "4 – A lot less noticeable" or "5 – No longer noticeable" at Week 48.
Endpoint(s): Occurrence of AEs and changes in vital signs and laboratory data., Proportion of participants achieving genital PhGVA of 0 or 1 at Week 48., Change from baseline in affected BSA in the genital region at Weeks 24 and 48., Proportion of participants achieving T-VASI50/75/90 at Weeks 24 and 48., Proportion of participants achieving a genital VNS of "4 – A lot less noticeable" or "5 – No longer noticeable" at Week 24., Proportion of participants in each category of the color-matching question at Weeks 24 and 48.

Source: https://euclinicaltrials.eu/ctis-public/view/2023-503737-22-00